EU clinical trial 2022-502242-27-00: A PHASE IV TRIAL TO CONFIRM THE EFFICACY OF OLAPARIB IN COMBINATION WITH BEVACIZUMAB AS MAINTENANCE FRONTLINE TREATMENT OF HRD POSITIVE OVARIAN TUMOURS (IOLANTHE)
Protocol code: IRFMN-OVA-8542
Sponsor: Mario Negri Institute For Pharmacological Research (Laboratory/Research/Testing facility). Phase: Therapeutic use (Phase IV). Countries: Italy (ongoing, recruitment ended).
Therapeutic area(s): Diseases [C] - Neoplasms [C04]
Gender: Female. Age: 18-64 years, 65+ years. Enrolment: 190.
Status: Ongoing, recruitment ended. Start date (EU): 2023-06-16. Decision date: 2023-06-16. Results received: No. Last updated: 2026-06-11.

Condition(s): Patients with a confirmation of advanced, high grade epithelial ovarian, fallopian tube or primary peritoneal cancer at surgery or at diagnostic biopsy and fulfilling the eligibility criteria to start a chemotherapy regimen in association with bevacizumab. Tumor samples at surgery will be retrieved and evaluated for the HRD status by Myriad Mychoice CDxPlus test. After surgery patients will start a standard platinum-based chemotherapy plus bevacizumb. Patients who will be in complete or partial response after frontline platinum-based chemotherapy plus bevacizumab and with HRD-positive tumor according to the Myriad Mychoice CDx Plus evaluation (including BRCA1-2 mutated tumors) and fulfilling specific eligibility criteria, will start to take olaparib in addition to bevacizumab as maintenance therapy.
Product: PACLITAXEL, CARBOPLATIN, BEVACIZUMAB, Lynparza 150 mg film-coated tablets, Lynparza 100 mg film-coated tablets

Primary endpoint: The efficacy will be evaluated in terms of PFS rate at 24 months. PFS will be defined as the time from the start of olaparib therapy until disease progression or death whichever comes first
Endpoint(s): Compliance in terms of treatment modifications and the duration of treatment with olaparib. The safety profile of olaparib in terms of: maximum toxicity grade experienced by each patient, for each toxicity; grade 3-4 toxicity for each type of toxicity; type, frequency, and nature of SAEs, SADR, SUSAR. Efficacy in terms of PFS2, which is defined as the time from starting olaparib to the second progression or death whichever comes first.

Source: https://euclinicaltrials.eu/ctis-public/view/2022-502242-27-00